EU clinical trial 2023-506661-65-00: A Phase 1 Randomized Study to Evaluate the Effect of Food on the Bioavailability of BMS-986158 in Participants with Advanced Solid Tumors.
Protocol code: CA011-1010
Sponsor: Bristol-Myers Squibb Services Unlimited Company (Pharmaceutical company). Phase: Human Pharmacology (Phase I)- Other. Countries: Spain (ended).
Therapeutic area(s): Diseases [C] - Neoplasms [C04]
Gender: Female, Male. Age: 18-64 years, 65+ years. Enrolment: 40.
Status: Ended. End date (EU): 2024-03-08. Decision date: 2023-12-11. Results received: No. Last updated: 2023-12-11.

Condition(s): Advanced Solid Tumors

Source: https://euclinicaltrials.eu/ctis-public/view/2023-506661-65-00